EU clinical trial 2024-513924-41-01: Suboxone (buprenorphine/naloxone) versus methadone opioid rotation in patients with escalated opioid use and chronic pain: a randomized trial (SUMO study).
Sponsor: Stichting Radboud universitair medisch centrum (Hospital/Clinic/Other health care facility). Phase: Therapeutic use (Phase IV). Countries: Netherlands (ongoing, recruiting).
Therapeutic area(s): Psychiatry and Psychology [F] - Mental Disorders [F03]
Gender: Female, Male. Age: 18-64 years, 65+ years. Enrolment: 100.
Status: Ongoing, recruiting. Start date (EU): 2022-05-11. Decision date: 2024-09-19. Results received: No. Last updated: 2024-09-19.

Condition(s): Opioid use disorder (DSM-5); chronic non-cancer pain (ICD-11).
Product: METHADONE, Suboxone 2 mg/0.5 mg sublingual tablets

Primary endpoint: The mean score on the Current Opioid Misuse Measure (COMM) questionnaire compared from baseline to two months after initiation of treatment between the suboxone and methadone treatment groups.
Endpoint(s): The mean scores on the following measures, compared between both treatments from baseline to two and six months after initiation of treatment. Questionnaires: COMM, VAS-pain, BPI, CSI, VAS-QOL, WHOQOLBREF, DASS, VAS-craving, OCDS, GPE, ORSDS, FFMQ-SF, SCS, TCQ, CFQ. Tests: quantitative sensory testing, 6-minutes walking test, urine toxicology, MoCA, 15WT, SCWT, PASAT. Other: dose of drug, treatment retention.

Source: https://euclinicaltrials.eu/ctis-public/view/2024-513924-41-01